EU clinical trial 2023-508546-17-00: Targeting non-Luminal disease by PAM50 with pembrolizumab + paclitaxel in Hormone Receptor-positive/HER2-negative advanced/metastatic breast cancer, who have progressed on or after CDK 4/6 inhibitor treatment (TATEN trial)
Protocol code: SOLTI-1716
Sponsor: Solti Group (Pharmaceutical company). Phase: Therapeutic exploratory (Phase II). Countries: Spain (ended).
Therapeutic area(s): Diseases [C] - Neoplasms [C04]
Gender: Female, Male. Age: 18-64 years, 65+ years. Enrolment: 46.
Status: Ended. Start date (EU): 2020-07-01. End date (EU): 2024-04-30. Decision date: 2023-12-11. Results received: Yes. Last updated: 2024-03-22.

Condition(s): Pre and post-menopausal women with locally advanced or metastatic HR+/HER2-negative endocrine resistant breast cancer
Product: KEYTRUDA 25 mg/mL concentrate for solution for infusion

Primary endpoint: Overall Response rate (ORR) defined as the proportion of patients with best overall response of complete response (CR) or partial response (PR), as per local investigator´s assessment and according to Response Evaluation Criteria in Solid Tumors (RECIST) version 1.1 criteria (see Appendix 5).
Endpoint(s): Clinical Benefit Rate (CBR) defined as the proportion of patients with a best overall response of CR, PR or an overall lesion response of Stable Disease (SD) or Non-PR/Non-progression disease (PD) lasting ≥ 24 weeks, based on local investigator´s assessment according to RECIST v1.1., Progression free survival (PFS) defined as the time from allocation to the first occurrence of disease progression, as determined locally by the investigator through the use of RECIST v.1.1, or death from any cause, whichever occurs first., Duration of response (DoR) defined as the time from the first occurrence of a documented objective response to disease progression, as determined locally by the investigator through use of RECIST v.1.1, or death from any cause, whichever occurs first, Time to response (TtR) defined as the time from allocation to the first objective tumor response (tumor shrinkage of ≥30%) observed for patients who achieved a CR or PR, Overall survival (OS) defined as the time from allocation to death from any cause (OS will be determined at the end of the study). 6. PFS on study treatment compared to PFS on prior line of therapy (pre- PFS)., PFS on study treatment compared to PFS on prior line of therapy (pre- PFS), ORR according to PD1 mRNA expression, ORR according to early dynamic changes in ctDNA between baseline and after 1 cycle of pembrolizumab., PFS according to early dynamic changes in ctDNA between baseline and after 1 cycle of pembrolizumab.

Source: https://euclinicaltrials.eu/ctis-public/view/2023-508546-17-00